EU clinical trial 2024-518761-10-00: KEYMAKER-U01 Substudy 01H: A Phase 2, Randomized, Umbrella Study With Rolling Arms of Investigational Agents in Participants with Previously Treated Stage IV Nonsquamous Non-small Cell Lung Cancer (NSCLC)
Protocol code: MK-3475-01H
Sponsor: Merck Sharp & Dohme LLC (Pharmaceutical company). Phase: Therapeutic exploratory (Phase II). Countries: Poland (ongoing, recruiting), Italy (ongoing, recruiting), Germany (ongoing, recruiting), Greece (ongoing, recruiting), Spain (ongoing, recruiting), Hungary (ongoing, recruiting).
Therapeutic area(s): Diseases [C] - Neoplasms [C04]
Gender: Female, Male. Age: 18-64 years, 65+ years. Enrolment: 41.
Status: Ongoing, recruiting. Start date (EU): 2025-08-25. Decision date: 2025-08-13. Results received: No. Last updated: 2026-07-30.
Decision dates by country: PL: 2025-08-18, DE: 2025-08-13, ES: 2025-08-13, GR: 2025-08-14, IT: 2025-08-14, HU: 2025-08-18

Condition(s): Non-small Cell Lung Cancer
Product: Raludotatug Deruxtecan, Ifinatamab Deruxtecan, DOCETAXEL

Primary endpoint: Objective Response (OR), Percentage of participants with at least one adverse event (AE), Percentage of participants who discontinued medication due to an AE
Endpoint(s): Duration Of Response (DOR), Progression-Free Survival (PFS), Overall Survival (OS)

Source: https://euclinicaltrials.eu/ctis-public/view/2024-518761-10-00